EU clinical trial 2024-519131-42-02: F-puff_SE_2024
Sponsor: Semmelweis University (Educational Institution). Phase: Therapeutic use (Phase IV). Countries: Hungary (authorised, recruitment pending).
Therapeutic area(s): Not possible to specify
Gender: Female, Male. Age: 18-64 years, 65+ years. Enrolment: 50.
Status: Authorised, recruitment pending. Decision date: 2025-10-22. Results received: No. Last updated: 2025-12-09.

Condition(s): PAIN MANAGEMENT
Product: Fentanyl Kalceks 50 mikrogramm/ml oldatos injekció, Fentanyl Sandoz 50 mikrogramm/ml oldatos injekció

Primary endpoint: responder rate (on NPRS scale)

Source: https://euclinicaltrials.eu/ctis-public/view/2024-519131-42-02